EU clinical trial 2023-509086-20-00: A SINGLE-CENTER, RANDOMIZED, PLACEBO-CONTROLLED STUDY TO ASSESS SAFETY, TOLERABILITY, AND PHARMACOKINETICS OF REPEAT DOSES OF ARM210 IN HEALTHY SUBJECTS.
Protocol code: CL1-210-03
Sponsor: Armgo Pharma Inc. (Pharmaceutical company). Phase: Human Pharmacology (Phase I)- Other. Countries: Netherlands (ended).
Therapeutic area(s): Diseases [C] - Musculoskeletal Diseases [C05]
Gender: Female, Male. Age: 18-64 years. Enrolment: 8.
Status: Ended. Start date (EU): 2024-02-13. End date (EU): 2024-05-03. Decision date: 2024-02-02. Results received: No. Last updated: 2024-02-02.

Condition(s): Cardiac arrhythmias

Source: https://euclinicaltrials.eu/ctis-public/view/2023-509086-20-00